EU clinical trial 2026-525543-32-00: A study to investigate how a single dose of the drug melflufen reaches brain tumor tissue, and how it affects the tumour, in patients who are already scheduled for surgery for a returning glioblastoma
Protocol code: OP-701
Sponsor: Oncopeptides AB (Pharmaceutical company). Phase: Human Pharmacology (Phase I)- Other. Countries: Norway (authorised, recruiting).
Therapeutic area(s): Diseases [C] - Nervous System Diseases [C10]; Diseases [C] - Neoplasms [C04]
Gender: Female, Male. Age: 18-64 years, 65+ years. Enrolment: 10.
Status: Authorised, recruiting. Start date (EU): 2026-06-17. Decision date: 2026-05-15. Results received: No. Last updated: 2026-05-15.

Condition(s): Recurrent glioblastoma

Source: https://euclinicaltrials.eu/ctis-public/view/2026-525543-32-00